EU clinical trial 2024-511380-29-00: A Phase 1 study to test the safety of an oral investigational drug (either AG-120 or AG-221) in combination with standard chemotherapeutic treatment for patients newly diagnosed with a blood malignancy (AML) with an IDH1 mutation and/or IDH2 mutation
Protocol code: AG120-221-C-001
Sponsor: Institut De Recherches Internationales Servier IRIS (Pharmaceutical company). Phase: Human Pharmacology (Phase I)- Other. Countries: Netherlands (ongoing, recruitment ended).
Therapeutic area(s): Diseases [C] - Hemic and Lymphatic Diseases [C15]
Gender: Female, Male. Age: 18-64 years, 65+ years. Enrolment: 2.
Status: Ongoing, recruitment ended. Start date (EU): 2015-12-16. Decision date: 2024-09-23. Results received: No. Last updated: 2025-10-16.

Condition(s): Newly Diagnosed Acute Myeloid Leukemia with an IDH1 and/or IDH2 Mutation

Source: https://euclinicaltrials.eu/ctis-public/view/2024-511380-29-00